EU clinical trial 2024-517400-11-00: Impact of 18F-fluoroestradiol (FES) Positron Emission Tomography (PET) on the therapeutic treatment of patients with ER+ and HER2- metastatic breast cancer in relapse after first-line therapy combining hormone therapy
Protocol code: 2021-FES-ESTROTIMP-4
Sponsor: GE Healthcare Limited (Pharmaceutical company). Phase: Therapeutic use (Phase IV). Countries: France (ended).
Therapeutic area(s): Diseases [C] - Hormonal diseases [C19]; Diseases [C] - Neoplasms [C04]
Gender: Female. Age: 18-64 years, 65+ years. Enrolment: 165.
Status: Ended. Start date (EU): 2024-10-24. End date (EU): 2025-12-26. End date: 2025-12-27. Decision date: 2024-10-24. Results received: No. Last updated: 2024-10-24.

Condition(s): Patients with metastatic breast cancer initially presenting with overexpression of estrogen receptors (ERs) and absence of overexpression of HER2, relapsing after a first therapeutic line combining hormone therapy.
Product: FLUOROESTRADIOL F-18

Primary endpoint: 1. The therapeutic impact will be assessed by the percentage of patients for whom a substantial therapeutic measure has been implemented following the analysis of the PET-FES examination. This evaluation will be done using a standardized questionnaire filled in by the prescribing clinician prospectively, when requesting PET / CT at FES. This questionnaire will be completed again within a maximum of 15 days after the PET / CT FES in order to specify the final therapeutic measure., 1 cont. The treatment modality initially planned and that finally implemented can be determined in the RCP according to thecenters. For the same patient, the questionnaire will be completed by the same investigator. Any modification of:-therapeutic modalities•change in the type of hormone therapy molecule • addition of a hormone therapy molecule • withdrawal of a hormone therapy molecule • change in the type of chemotherapy molecule • addition of a chemotherapy molecule, 1 cont.change in the type of other systemic treatment molecule•addition of other type of systemic treatment molecule•withdrawal of other type of systemic treatment molecule•addition of radiotherapy treatment•stopping radiotherapy treatment•change in radiotherapy technique•change in radiotherapy protocol•enlarged irradiation field of an already identified area•restricted irradiation field of an already identified area•programming of surgery•deprogramming of surgery, - diagnostic modalities: • addition of a complementary exam • withdrawal of an additional examination • performing a biopsy - monitoring methods • adding an exam • withdrawal of an exam • increased frequency of follow-up • decrease in frequency of follow-up
Endpoint(s): 2nd line progression-free survival (PFS) is defined as the time between the date of the final therapeutic measure (treatment decision) and relapse, by comparing the medians of progression-free survival (PFS) in the study population and in the cohort historical. The comparison will be made by the Kaplan Meier test with a 12-month censorship., The relevance of the therapeutic measures put in place following the baseline PET / CT FES will be determined at 3 months on all the data in the patient's medical file (including the evaluation of the response to treatment) of the patient by an independent jury clinicians, made up of expert physician (oncologist, nuclear physician, radiotherapist, radiologist).

Source: https://euclinicaltrials.eu/ctis-public/view/2024-517400-11-00